EU clinical trial 2025-521302-17-00: PRODIGE 118 - PEHRICCA : PErioperative CISGEM plus RILVEGOSTOMIG in High-Risk resectable Intrahepatic CholangioCarcinoma Phase II single arm study -mutlicenter
Protocol code: PRODIGE 118-PEHRICCA
Sponsor: Fondation Franc.Cancerologie Digestive (Hospital/Clinic/Other health care facility). Phase: Phase II and Phase III (Integrated). Countries: France (ongoing, recruitment ended).
Therapeutic area(s): Diseases [C] - Neoplasms [C04]
Gender: Female, Male. Age: 18-64 years, 65+ years. Enrolment: 49.
Status: Ongoing, recruitment ended. Start date (EU): 2026-05-26. Decision date: 2025-10-15. Results received: No. Last updated: 2026-05-06.

Condition(s): Hihg risk of cholangiocarcinoma intra hépatic resectable
Product: Gemcitabine Eugia 40 mg/ml solution à diluer pour perfusion, RILVEGOSTOMIG, Cisplatine Teva 1 mg/ml solution à diluer pour perfusion.

Primary endpoint: The primary endpoint of the study is the Progression-Free survival at 12 months. Events to consider for the evaluation of the endpoint are: - Progression (local or metastatic) during the pre-operative chemotherapy - Progression (local or metastatic) during post-operative chemotherapy - Death (all cause)
Endpoint(s): Resection rate: This rate is defined as the proportion of patients who could benefit from surgery after the pre-operative chemotherapy. Types of resections will also be collected (R0/R1/R2), Dropout rate before surgery: This rate is defined as the proportion of patients who could not benefit from surgery after pre-operative chemotherapy, Overall survival (OS): OS is defined by the time between the date of inclusion and the date of death (regardless of the cause). Alive patients will be censored at the date of their last news, Best Response: The response is defined regarding RECIST 1.1 criteria evaluated using pre-operative imageries during treatment. Best response will be classified as: - Objective Response: patients with partial or complete response. - Stability - Progression, Disease-Free survival (DFS): DFS is defined by the time between the date of surgery and the date of first local or metastatic progression or death (regardless of the cause) Alive patients without progression will be censored at the date of their last news, Pathological response (resected patients): This endpoint will be evaluated according to the TRG (Rubbia-Brandt L et al. Annals Oncol 2007) 20. This response is evaluated according to the various categories: TRG1/TRG 2/TRG 3/TRG 4/TRG 5, Adverse events: Adverse events will be evaluated according to NCI-CTC v5.0.and complications post operation according to Clavien-Dindo classification, Percentage of pre-operative and post-operative completion (4 cycles planned) is defined as the percentage of patients who received the 4 cycles of chemotherapy even if doses are partially or not delivered for a product. The percentage will be calculated separately for pre and post-operative periods, Quality of life: The QLQ-C30 is a cancer-specific tool composed of 30 items. Five functional scores (physical, role, cognitive, social, and emotional), a global health score ranging from 0 (worst) to 100 (best) have been developed as well as 9 symptom scores (nausea, pain, fatigue, dyspnea, difficulty sleeping, anorexia, constipation, diarrhea and perceived financial difficulties) ranging from 0 (best) to 100 (worse).

Source: https://euclinicaltrials.eu/ctis-public/view/2025-521302-17-00